EU clinical trial 2024-514201-61-00: A 24 weeks proof of concept study to evaluate the clinical, MRI and synovial tissue benefit of Sarilumab in active RA patients despite TNF agents
Protocol code: P1200_51
Sponsor: Cliniques Universitaires Saint-Luc (Hospital/Clinic/Other health care facility). Phase: Therapeutic use (Phase IV). Countries: Belgium (ongoing, recruiting).
Therapeutic area(s): Not possible to specify
Gender: Female, Male. Age: 18-64 years, 65+ years. Enrolment: 30.
Status: Ongoing, recruiting. Start date (EU): 2019-12-10. Decision date: 2024-07-30. Results received: No. Last updated: 2026-01-23.

Condition(s): Rheumatoid arthritis
Product: Kevzara 200 mg solution for injection in pre-filled syringe

Primary endpoint: To study the global gene expression profiles, as well as pathological and immunohistochemical characteristics of synovial biopsies obtained in these RA patients and ACR 20, 50 and EULAR response at week 12

Source: https://euclinicaltrials.eu/ctis-public/view/2024-514201-61-00